EU clinical trial 2024-519326-20-00: A phase 2, three-arm, randomized study of the efficacy of intratumorally administered L19IL2 or L19TNF or L19IL2/L19TNF, all in combination with systemic anti-PD1 pembrolizumab, in stage III and IV unresectable melanoma patients with resistance to or progressing upon anti-PD1 checkpoint inhibitors and with presence of injectable metastases
Protocol code: PH-ICKPD1-02/21
Sponsor: Philogen S.p.A. (Pharmaceutical company). Phase: Therapeutic exploratory (Phase II). Countries: Italy (authorised, recruiting), Germany (authorised, recruiting).
Therapeutic area(s): Diseases [C] - Neoplasms [C04]
Gender: Female, Male. Age: 18-64 years, 65+ years. Enrolment: 65.
Status: Authorised, recruiting. Start date (EU): 2026-06-08. Decision date: 2026-01-14. Results received: No. Last updated: 2026-01-15.
Decision dates by country: DE: 2026-01-15, IT: 2026-01-14

Condition(s): Patients with diagnosis of unresectable clinical stage III or IV metastatic melanoma, with presence of injectable cutaneous, subcutaneous or nodal lesions and resistant to or progressing upon anti-PD1 immunotherapy
Product: KEYTRUDA 25 mg/mL concentrate for solution for infusion., Darleukin, Fibromun

Primary endpoint: Primary endpoint of the study is the Confirmed Objective Response Rate (ORR = CR + PR) over a period of up to 2 years after first intralesional treatment, according to RECIST v1.1 criteria in each arm of the study. The primary analysis will be performed in the Intention-to-Treat population (ITT).

Source: https://euclinicaltrials.eu/ctis-public/view/2024-519326-20-00